EU clinical trial 2024-517362-41-00: PRODIGE 54 SAMCO : MULTICENTER RANDOMIZED PHASE II STUDY COMPARING THE EFFECTIVENESS AND TOLERANCE OF AVELUMAB VERSUS STANDARD 2nd LINE TREATMENT CHEMOTHERAPY IN PATIENTS WITH COLORECTAL METASTATIC CANCER WITH MICROSATELLITE INSTABILITY (MSI)
Protocol code: Prodige 54 SAMCO
Sponsor: Fondation Franc.Cancerologie Digestive (Hospital/Clinic/Other health care facility). Phase: Therapeutic exploratory (Phase II). Countries: France (ended).
Therapeutic area(s): Diseases [C] - Neoplasms [C04]
Gender: Female, Male. Age: 18-64 years, 65+ years. Enrolment: 132.
Status: Ended. Start date (EU): 2018-04-24. End date (EU): 2025-05-07. Decision date: 2024-09-27. Results received: Yes. Last updated: 2025-02-19.

Condition(s): COLORECTAL METASTATIC CANCER WITH MICROSATELLITE INSTABILITY
Product: OXALIPLATIN, AFLIBERCEPT, PANITUMUMAB, BEVACIZUMAB, Folinic acid (as calcium folinate) 10 mg/ml solution for injection/infusion, IRINOTECAN, FLUOROURACIL, CETUXIMAB, AVELUMAB

Primary endpoint: The primary endpoint is radiographic progression-free survival (PFS). The progression will assessed by the investigator according to RECIST v1.1 criteria in arm A and B, PFS is defined by the time between the date of randomization and the date of the first radiological progression or the date of death (for whatever reason). Patients alive without radiological progression will be censored on the date of their last CT-scan.
Endpoint(s): Time To Progression (TTP): This time is defined by the time between the date of randomization and the date of the first radiological progression. Patients alive or dead without radiological progression will be censored on the date of their latest CT-scan, Overall survival (OS): OS is defined by the time between the date of randomization and the date of death (regardless of the cause). Alive patients will be censored at the date of their last news., Objective Response Rate : Objective Response rate is defined by patients with partial or complete response., Time to Best Response (TBR) This time is defined as the time from the date of randomization and the date of best response under treatment. Patients without imaging (better response non-evaluable, untreated patients) will not be taken into account in the analysis., The best response under treatment: The best tumor response will be evaluated throughout the treatment. The response is evaluated according to the various categories: complete, partial, stability, progression or non-evaluable response., Toxicities: Toxicity will be evaluated according to NCI-CTC v4.0., Early tumor shrinkage at 8 weeks: This endpoint is defined as the relative difference between the sum of the largest diameters of target lesions at 8 weeks and this sum at baseline. Early decrease corresponds to a relative difference of > 20% and > 30% in RECIST v1.1., Depth of response: This criterion is defined as the relative difference between the sum of the largest diameters of target lesions in the NADIR (in the absence of new lesions or progression of non-target lesions) and the sum of the largest diameters of the target lesions at inclusion, Secondary resection rate: This rate is defined as the proportion of patients who could benefit from surgery of their metastases (optionally combined with a surgery of the primary tumor) during 2nd line treatment., Histological response if resection: This endpoint will be evaluated according to the TRG (Rubbia-Brandt L et al. Annals Oncol 2007), in patients who underwent a secondary resection of their metastases (possibly associated with surgery of the primary tumor). This response is evaluated according to the various categories: TRG1/TRG 2/TRG 3/TRG 4/TRG 5., Evolution of CEA markers: The markers will be collected at each treatment cycle. The evolution of the markers will be analysed by a graphic representation of the percentage change from baseline rate., Quality of life: Quality of life will be assessed according to the questionnaire of EORTC QLQ-C30.

Source: https://euclinicaltrials.eu/ctis-public/view/2024-517362-41-00